EU clinical trial 2024-512260-54-00: An Open-Label Roll-Over Study to Evaluate the Long-Term Safety and Efficacy of DCR-PHXC Solution for Injection (subcutaneous use) in Patients with Primary Hyperoxaluria
Protocol code: DCR-PHXC-301
Sponsor: Dicerna Pharmaceuticals Inc. (Pharmaceutical company). Phase: Therapeutic confirmatory (Phase III). Countries: France (ongoing, recruitment ended), Germany (ongoing, recruitment ended), Netherlands (ongoing, recruitment ended), Norway (ongoing, recruitment ended), Spain (ongoing, recruitment ended), Italy (ongoing, recruitment ended).
Therapeutic area(s): Diseases [C] - Nutritional and Metabolic Diseases [C18]
Gender: Female, Male. Age: 0-17 years, 18-64 years. Enrolment: 29.
Status: Ongoing, recruitment ended. Start date (EU): 2019-08-20. Decision date: 2024-07-29. Results received: No. Last updated: 2026-05-22.
Decision dates by country: NO: 2024-07-29, NL: 2024-07-30, DE: 2024-07-30, ES: 2024-07-29, IT: 2024-09-09, FR: 2024-08-27

Condition(s): Primary Hyperoxaluria

Primary endpoint: The annual rate of decline in eGFR in participants with PH1
Endpoint(s): Key Secondary: 1. The incidence and severity of TEAE and SAE, Key Secondary: 2. Change from Baseline in 12-lead ECG, physical examination findings, vital signs, and clinical laboratory tests (hematology, chemistry, coagulation parameters, and urinalysis), The proportion of participants with a 24-hour Uox level (< 0.46 mmol/24 hours or ≥ 0.46 - < 0.60 mmol/24 hours [adjusted per 1.73 m2 BSA in participants aged < 18 years]) at each assessment time point throughout the study in PH1, PH2, and PH3 participant subgroups, The percentage of participants with spot urinary oxalate-to-creatinine ratio ≤ the ULN or ≤ 1.5 x ULN at each assessment time point throughout the study in PH1, PH2, and PH3 participant subgroups, Change from Baseline in the number of stone events over a 12-month period, annually in Year 1, Year 2, etc. in PH1, PH2, and PH3 participant subgroups, Change from Baseline in the stone burden and nephrocalcinosis grade at Year 1, Year 2, etc. in PH1, PH2, and PH3 participant subgroups, The number of participants with severe CKD (GFR = 15-29 mL/min) or ESRD (GFR < 15 mL/min); adjusted per 1.73 m2 BSA in participants aged < 18 years in PH1, PH2, and PH3 participant subgroups, Change from Baseline in the SF-36 and EQ-5D-5L in adults; and in the PedsQL in children in PH1, PH2, and PH3 participant subgroups, AUC of 24-hour Uox from Day 90 to Day 180, based on percent change from Baseline in PH1, PH2, and PH3 participant subgroups. This endpoint will only be assessed in participants randomized to placebo in a previous study of DCR-PHXC and pediatric siblings, Percent change from Baseline in 24-hour Uox at each assessment time point throughout the study in PH1, PH2, and PH3 participant subgroups. In those participants randomized to placebo in a previous study of DCR-PHXC and pediatric siblings, this endpoint will be assessed only after Month 6, Percent and absolute change from Baseline in spot urinary oxalate-to-creatinine ratio at each assessment time point throughout the study in PH1, PH2, and PH3 participant subgroups. In pediatric siblings, this endpoint will be assessed only after Month 6, Exploratory: The annual rate of decline in eGFR in participants with PH2 and PH3

Source: https://euclinicaltrials.eu/ctis-public/view/2024-512260-54-00